EU clinical trial 2026-525972-25-00: FOSFORMEN : Randomized, multicenter, non-inferiority trial comparing the efficacy of fosfomycin versus fluoroquinolones or cotrimoxazole as oral follow-up treatment in febrile urinary tract infections in men caused by susceptible enterobacteria
Protocol code: APHP240801
Sponsor: Assistance Publique Hopitaux De Paris (Hospital/Clinic/Other health care facility). Phase: Therapeutic confirmatory (Phase III). Countries: France (authorised, recruitment pending).
Therapeutic area(s): Diseases [C] - Male Urogenital Diseases [C12]; Diseases [C] - Bacterial Infections and Mycoses [C01]
Gender: Male. Age: 18-64 years, 65+ years. Enrolment: 312.
Status: Authorised, recruitment pending. Decision date: 2026-07-16. Results received: No. Last updated: 2026-07-16.

Condition(s): Febrile male urinary tract infections caused by Escherichia coli
Product: OFLOXACIN, FOSFOMYCIN, SULFAMETHOXAZOLE AND TRIMETHOPRIM, LEVOFLOXACIN, CIPROFLOXACIN

Primary endpoint: The primary endpoint will be a binary outcome, defined as clinical cure (body temperature < 38°C and absence of urinary tract infection symptoms), without the need for additional antibiotic therapy up to the primary evaluation on Day 26, which corresponds to 14 days after completion of a 12-day antibiotic treatment assigned by randomization.
Endpoint(s): To compare between the two groups (experimental treatment : oral FT vs. Standard treatment : oral FQ or oral TMP-SMX) the cumulative incidence of infectious and urological complications, To compare between the two groups (experimental treatment : oral FT vs. Standard treatment : oral FQ or oral TMP-SMX) adherence to treatment, occurrence, nature, and severity of adverse events related to antibiotics, To compare between the two groups (experimental treatment : oral FT vs. Standard treatment : oral FQ or oral TMP-SMX) rectal carriage of phenotypically antibiotic-resistant Enterobacterales (resistant to FQ, TMP-SMX, fosfomycin, and thired-generation cephalosporins) on Day 26, i.e., 14 days after completion of the randomized antibiotic treatment, To compare between the two groups (experimental treatment : oral FT vs. Standard treatment : oral FQ or oral TMP-SMX) rates of recurrence of febrile or non-febrile UTIs (relapse or reinfection), assessed on Day40, i.e., 28 days after completion of the randomized antibiotic treatment, To compare between the two groups (experimental treatment : oral FT vs. Standard treatment : oral FQ or oral TMP-SMX) analysis of clinical and biological characteristics of patients who experienced treatment failure compared to those who were cured during the initial episode.

Source: https://euclinicaltrials.eu/ctis-public/view/2026-525972-25-00